EU clinical trial 2024-515469-32-00: ApproaCH: A Phase 2b, Multicenter, Double-Blind, Randomized, Placebo-controlled Trial evaluating Efficacy and Safety of Subcutaneous Doses of TransCon CNP Administered Once Weekly for 52 Weeks in Children with Achondroplasia followed by an Open Label Extension period
Protocol code: ASND0036
Sponsor: Ascendis Pharma Growth Disorders A/S (Pharmaceutical company). Phase: Therapeutic exploratory (Phase II). Countries: Ireland (ended), Spain (ended), Denmark (ended).
Therapeutic area(s): Diseases [C] - Musculoskeletal Diseases [C05]
Gender: Female, Male. Age: 0-17 years. Enrolment: 42.
Status: Ended. Start date (EU): 2023-03-02. End date (EU): 2025-08-13. End date: 2025-08-14. Decision date: 2024-09-26. Results received: No. Last updated: 2025-03-19.
Decision dates by country: DK: 2024-10-02, IE: 2024-09-26, ES: 2024-10-01

Condition(s): Achondroplasia in Children and Adolescents
Product: TransCon CNP, Placebo for TransCon CNP

Primary endpoint: Annualized growth velocity (AGV) at Week 52
Endpoint(s): Change from baseline in height Z-score at Week 52

Source: https://euclinicaltrials.eu/ctis-public/view/2024-515469-32-00